EU clinical trial 2025-522970-35-00: REVERsal to normoglycemia by Treating PREDIABETES: the REVERT-PREDIABETES trial
Sponsor: Region Midtjylland (Hospital/Clinic/Other health care facility). Phase: Phase III and phase IV (Integrated). Countries: Denmark (ongoing, recruiting).
Therapeutic area(s): Diseases [C] - Cardiovascular Diseases [C14]; Diseases [C] - Nutritional and Metabolic Diseases [C18]
Gender: Female, Male. Age: 18-64 years, 65+ years. Enrolment: 158.
Status: Ongoing, recruiting. Start date (EU): 2026-03-03. Decision date: 2025-11-23. Results received: No. Last updated: 2025-11-23.

Condition(s): Coronary artery disease, Prediabetes
Product: DAPAGLIFLOZIN, SEMAGLUTIDE

Primary endpoint: Presence of a composite of retinopathy, nephropathy, neuropathy, and MASLD in patients with chronic coronary syndrome and prediabetes versus normoglycemia., Incidence of normoglycemia defined as HbA1c <39 mmol/mol after 1 year in the interventional therapy arm compared with conventional therapy.
Endpoint(s): To examine the 2-year incidence of recurrence of prediabetes or progression to type 2 diabetes in patients with chronic coronary syndrome and initial prediabetes treated with glucose-lowering medications for one year compared with conventional therapy., Baseline presence of a composite of retinopathy, nephropathy, and neuropathy in patients with chronic coronary syndrome and prediabetes versus normoglycemia.., Baseline presence of retinopathy, nephropathy, neuropathy or MASLD, respectively, in patients with chronic coronary syndrome and prediabetes versus normoglycemia., 1-year incidence of normoglycemia defined as HbA1c <42 mmol/mol, Change in HbA1c, Change in eGFR, Change in cystatin-C, Change in hs-CRP, Change in lipid parameters, Change in c-peptide, Change in HOMA-IR, Change in Fib-4, Change in CD163, Change in PRO-C3, Change in MASLD severity, Change in urine albumin-creatinine ratio, Change in weight, Change in waist circumference, 2-year incidence of type 2 diabetes in the interventional therapy arm compared with conventional therapy., Prevalence of prediabetes defined as HbA1c 42-47 mmol/mol in the interventional therapy arm compared with conventional therapy., Prevalence of prediabetes defined as HbA1c 39-47 mmol/mol in the interventional therapy arm compared with conventional therapy.

Source: https://euclinicaltrials.eu/ctis-public/view/2025-522970-35-00